EU clinical trial 2023-509401-71-00: A Phase 3, Multicenter, Randomized, Double-Blind, Placebo Controlled, Parallel-Group Study with an Open-Label Extension to Evaluate the Efficacy and Safety of Oral Rilzabrutinib (PRN1008) in Adults and Adolescents with Persistent or Chronic Immune Thrombocytopenia (ITP).
Protocol code: EFC17093
Sponsor: Principia Biopharma Inc. (Pharmaceutical company). Phase: Therapeutic confirmatory (Phase III). Countries: Hungary (ended), Spain (ended), Italy (ended), Poland (ended), Norway (ended), France (ended), Germany (ended).
Therapeutic area(s): Diseases [C] - Hemic and Lymphatic Diseases [C15]
Gender: Female, Male. Age: 0-17 years, 18-64 years, 65+ years. Enrolment: 53.
Status: Ended. Start date (EU): 2021-02-05. End date (EU): 2025-05-15. Decision date: 2024-04-04. Results received: No. Last updated: 2025-11-24.
Decision dates by country: NO: 2024-04-04, DE: 2024-04-08, PL: 2024-05-16, FR: 2024-04-05, HU: 2024-04-08, IT: 2024-04-08, ES: 2024-04-08

Condition(s): Immune Thrombocytopenia (ITP)
Product: Rilzabrutinib, Composition of placebo is identical to that of IMP except that 400mg active ingredient is replaced with 400mg mannitol.

Primary endpoint: 1. (EU and UK) Proportion of adult participants able to achieve platelet counts at or above 50,000/μL for at least 8 out of the last 12 weeks of the 24-week blinded treatment period in the absence of rescue therapy.
Endpoint(s): 1. Number of weeks with platelet count ≥50,000/μL OR between ≥30,000/μL and <50,000/μL and at least doubled from baseline over the 24-week blinded treatment period in the absence of rescue therapy., 2. Number of weeks with platelet counts ≥30,000/μL and at least doubled from baseline over the 24-week blinded treatment period in the absence of rescue therapy., 3. Time to first platelet count of ≥50,000/μL OR between ≥30,000/μL and <50,000/μL and doubled from baseline., 4. Proportion of paticipants requiring rescue therapy during the 24-week blinded treatment period., 5. Change from baseline on Item 10 of the ITPPatient Assessment Questionnaire in adult patients (≥18 years) at Week 13., 6. (EU and UK) Change from baseline in Idiopathic Thrombocytopenic Purpura Bleeding Scale (IBLS) assessment at Week 25., 7. Proportion of participants who able to achieve stable platelet response, within a period of 24 weeks following initial achievement of the platelet response., 8. Frequency and severity of Treatment Emergent Adverse Events., 9. Frequency and severity of bleeding TEAEs., 10. Plasma concentrations of rilzabrutinib., 11. Change from baseline on the Symptoms, Bother and Activity domains of the ITP Patient Assessment Questionnaire (ITP-PAQ) in adult patients (≥18 years)., 12. Change from baseline in disease-specific QoL as measured by the Kids’ ITP Tools (ITP-KIT) score in pediatric participants.

Source: https://euclinicaltrials.eu/ctis-public/view/2023-509401-71-00